EU clinical trial 2024-514102-32-00: Short-term GnRH- Antagonist Treatment to Lower LH Pulsatility in Women With PCOS Aiming to Improve Hormonal Functions - SOPKGANI
Protocol code: 2022_0016
Sponsor: Centre Hospitalier Universitaire De Lille (Hospital/Clinic/Other health care facility). Phase: Human Pharmacology (Phase I)- First administration to humans. Countries: France (ended).
Therapeutic area(s): Diseases [C] - Female Urogenital Diseases and Pregnancy Complications [C13]
Gender: Female. Age: 18-64 years. Enrolment: 20.
Status: Ended. Start date (EU): 2024-04-17. End date (EU): 2025-02-09. Decision date: 2024-11-08. Results received: No. Last updated: 2024-11-08.

Condition(s): Polycystic ovarian

Source: https://euclinicaltrials.eu/ctis-public/view/2024-514102-32-00